EU clinical trial 2024-518943-38-00: KETALGIA : Evaluation of the effectiveness of a ketamine infusion combined with magnesium sulfate in the treatment of chronic refractory cluster headache
Protocol code: RBHP 2020 MOISSET
Sponsor: University Hospital Of Clermont-Ferrand (Hospital/Clinic/Other health care facility). Phase: Therapeutic confirmatory (Phase III). Countries: France (ended).
Therapeutic area(s): Analytical, Diagnostic and Therapeutic Techniques and Equipment [E] - Anesthesia and Analgesia [E03]
Gender: Female, Male. Age: 18-64 years, 65+ years. Enrolment: 90.
Status: Ended. Start date (EU): 2021-09-15. End date (EU): 2025-12-23. Decision date: 2024-12-03. Results received: No. Last updated: 2025-12-17.

Condition(s): refractory chronic cluster headache
Product: CHLORURE DE SODIUM 0,9 % BAXTER, solution pour perfusion en poche, SULFATE DE MAGNESIUM LAVOISIER 15 POUR CENT (0,15 g/ml), solution injectable (I.V.) en ampoule, HYDROXYZINE RENAUDIN 100 mg/2 mL, solution injectable, KETAMINE RENAUDIN 50 mg/ml, solution injectable

Primary endpoint: Change in weekly frequency of crisis over the period D7-D13 compared to the pre-treatment period
Endpoint(s): Change in weekly frequency of crisis over the period D14-D20, D21-D27, D28-D34 compared to the pre-treatment period, The proportion of responders at 30%, 50% and 75% each week post-infusion, Response to treatment according to initial serum magnesium, The weekly frequency and intensity of crisis between the 7 days preceding the infusion and each week post infusion, Crisis treatments intake, Anxiety and depression scoring (HAD), The PGIC scoring for the overall clinical evaluation on D15 and D90, The proportion of patients requiring additional treatment on D15, Direct medical costs, Evaluation of adverse effects, Evaluation of blinding quality

Source: https://euclinicaltrials.eu/ctis-public/view/2024-518943-38-00